EU clinical trial 2022-502783-21-00: A Phase 3, Randomized, Open Label Study Evaluating the Efficacy and Safety of Odronextamab (REGN1979), an Anti-CD20 x Anti-CD3 Bispecific Antibody, versus Standard of Care Therapy in Participants with Relapsed/Refractory Aggressive B-cell non-Hodgkin Lymphoma (OLYMPIA-4)
Protocol code: R1979-HM-2299
Sponsor: Regeneron Pharmaceuticals Inc. (Pharmaceutical company). Phase: Therapeutic confirmatory (Phase III). Countries: Czechia (ended), Belgium (ended), Spain (ongoing, recruitment ended), Germany (ended), Italy (ended), Austria (ended), Poland (ended), Netherlands (ended), Hungary (authorised, recruitment pending), Romania (ongoing, recruitment ended).
Therapeutic area(s): Diseases [C] - Hemic and Lymphatic Diseases [C15]
Gender: Female, Male. Age: 18-64 years, 65+ years. Enrolment: 132.
Start date (EU): 2024-02-20. Decision date: 2023-09-11. Results received: No. Last updated: 2026-05-25.
Decision dates by country: BE: 2023-09-11, NL: 2024-05-14, AT: 2023-09-18, CZ: 2023-09-11, DE: 2023-09-14, IT: 2023-09-18, PL: 2023-09-18, HU: 2025-05-06, ES: 2023-09-11, RO: 2025-05-26

Condition(s): B-Cell Non-Hodgkin's Lymphoma
Product: DEXAMETHASONE, CYTARABINE, DEXAMETHASONE, CARBOPLATIN, ETOPOSIDE, IFOSFAMIDE, GEMCITABINE, Odronextamab, CISPLATIN, Odronextamab, RITUXIMAB, GEMCITABINE

Primary endpoint: Event-free survival (EFS) as assessed by independent central review (ICR)
Endpoint(s): Progression free survival (PFS) as assessed by ICR, Best overall response (BOR) as assessed by ICR, Overall survival (OS), Overall change in physical functioning as measured by scores of the physical function scale of the European Organization for Research and Treatment of Cancer Quality of Life Questionnaire-C30 (EORTC-QLQ-C30), EFS as assessed by local investigator, PFS as assessed by local investigator, BOR as assessed by local investigator, Complete response (CR) assessed by ICR and local investigator, Duration of response (DOR) assessed by ICR and local investigator, Incidence of treatment-emergent adverse events (TEAEs), Severity of TEAEs, Odronextamab concentrations in serum, Incidence of anti-drug antibodies (ADAs) to odronextamab over the study duration, Titers of ADAs to odronextamab over the study duration, Incidence of neutralizing antibodies (NAb) to odronextamab over the study duration, Measurable residual disease (MRD) status, Overall change in patient-reported outcomes (PROs), as measured by scores of the EORTCQLQ- C30, Overall change in PROs, as measured by scores of the Functional Assessment of Cancer Therapy–Lymphoma (FACT-LymS), Overall change in PROs, as measured by scores of the EuroQol-5 Dimension-5 Level Scale (EQ-5D-5L), Overall change in score of the Global Population item 5 (GP5) of the Functional Assessment of Cancer Therapy-General (FACT-G) questionnaire

Source: https://euclinicaltrials.eu/ctis-public/view/2022-502783-21-00